EU clinical trial 2025-523908-75-00: A Phase IIb, randomised, double-blind, placebo-controlled, multicentre study to evaluate the efficacy and safety of concomitant use of eplontersen and ALXN2220 compared with eplontersen and placebo in adult participants with transthyretin-mediated amyloid cardiomyopathy (ATTR-CM).
Protocol code: D8456C00001
Sponsor: AstraZeneca AB (Pharmaceutical company). Phase: Therapeutic exploratory (Phase II). Countries: Germany (authorised, recruitment pending), Italy (authorised, recruitment pending), Spain (authorised, recruitment pending), France (authorised, recruitment pending), Sweden (authorised, recruitment pending).
Therapeutic area(s): Diseases [C] - Cardiovascular Diseases [C14]
Gender: Female, Male. Age: 18-64 years, 65+ years. Enrolment: 158.
Status: Authorised, recruitment pending. Decision date: 2026-07-20. Results received: No. Last updated: 2026-07-24.
Decision dates by country: FR: 2026-07-22, DE: 2026-07-24, IT: 2026-07-24, ES: 2026-07-23, SE: 2026-07-20

Condition(s): Transthyretin-Mediated Amyloid Cardiomyopathy (ATTR-CM)
Product: Placebo for ALXN2220, Wainzua 45 mg solution for injection in pre-filled pen, Recombinant human anti-ATTR immunoglobulin G1 (IgG1) monoclonal antibody (mAb)

Primary endpoint: Change from baseline in CPET peak VO2
Endpoint(s): Change from baseline in ECV (subgroup)., Change from baseline in NT-proBNP., Change from baseline in KCCQ-CSS.

Source: https://euclinicaltrials.eu/ctis-public/view/2025-523908-75-00